EU clinical trial 2024-515008-38-00: A Phase III, Randomized, Double-blind, Multicenter, Global Study of Rilvegostomig or Pembrolizumab in Combination with Platinum-based Chemotherapy for the First-line Treatment of Patients with Metastatic Non-squamous Non-small Cell Lung Cancer Whose Tumors Express PD-L1 (ARTEMIDE-Lung03)
Protocol code: D702FC00001
Sponsor: AstraZeneca AB (Pharmaceutical company). Phase: Therapeutic confirmatory (Phase III). Countries: Italy (ongoing, recruiting), Poland (ongoing, recruiting), Spain (ongoing, recruiting), Hungary (ongoing, recruiting), France (ongoing, recruiting), Netherlands (ongoing, recruiting), Belgium (ongoing, recruiting), Germany (ongoing, recruiting).
Therapeutic area(s): Diseases [C] - Neoplasms [C04]
Gender: Female, Male. Age: 18-64 years, 65+ years. Enrolment: 241.
Status: Ongoing, recruiting. Start date (EU): 2025-02-14. Decision date: 2025-01-21. Results received: No. Last updated: 2026-05-25.
Decision dates by country: BE: 2025-01-22, FR: 2025-01-23, DE: 2025-01-23, HU: 2025-01-24, IT: 2025-01-24, ES: 2025-01-21, NL: 2025-01-22, PL: 2025-01-27

Condition(s): Metastatic Non-squamous Non-small Cell Lung Cancer Whose Tumors Express PD-L1
Product: KEYTRUDA 25 mg/mL concentrate for solution for infusion, MYCOPHENOLATE MOFETIL, PEMETREXED, INFLIXIMAB, Rilvegostomig, PEMETREXED, CISPLATIN, CARBOPLATIN

Primary endpoint: Overall Survival (OS)., Progression-free survival (PFS).
Endpoint(s): Landmark overall survival (OS) rates, Landmark progression-free survival (PFS) rates, Time to second progression or death (PFS2), Overall response rate (ORR), Duration of response (DoR), Concentration of rilvegostomig in serum., Presence of antidrug antibody (ADAs), titer and neutralizing antibodies for rilvegostomig., Proportion of participants with maintained or improved physical functioning., Time to deterioration (TTD) of global health status (GHS)/quality of life (QoL) and in pulmonary symptoms., Adverse events (AEs) (graded by CTCAE version 5.0), clinical laboratory assessments, vital signs, and Eastern Cooperative Oncology Group (ECOG) performance status.

Source: https://euclinicaltrials.eu/ctis-public/view/2024-515008-38-00